EU clinical trial 2024-513637-20-00: Phase II Study of Nivolumab (Group 1) and Nivolumab plus Relatlimab (Group 2) in Patients with Locally Advanced/ Metastatic Squamous Cell Carcinoma of the Skin
Sponsor: Gemeinnutzige Salzburger Landes kliniken Betriebsgesellschaft mbH (Hospital/Clinic/Other health care facility). Phase: Therapeutic exploratory (Phase II). Countries: Austria (ongoing, recruiting).
Therapeutic area(s): Diseases [C] - Neoplasms [C04]
Gender: Female, Male. Age: 18-64 years, 65+ years. Enrolment: 61.
Status: Ongoing, recruiting. Start date (EU): 2017-03-24. Decision date: 2024-08-12. Results received: No. Last updated: 2026-07-15.

Condition(s): Locally Advanced/Metastatic Squamous Cell Carcinoma of the Skin
Product: Nivolumab/Relatlimab, OPDIVO 10 mg/mL concentrate for solution for infusion.

Primary endpoint: To determine the Objective Response Rate (ORR) of immunotherapy with Nivolumab (Group 1) and Nivolumab plus Relatlimab (Group 2) in patients with locally advanced/metastativ squamous cell carcinoma of the skin using Response Criteria in Solid Tumors Version 1.1 (RECIST 1.1) per site assessment (Time Frame Group 2: From first dose up to 5 years)
Endpoint(s): Disease Control Rate (DCR) using Response Criteria in Solid Tumors version 1.1 (RECIST 1.1) per site assessment (Time Frame (Group 2): from first dose to date of first documented tumor progression or death, whichever comes first (up to 5 years)), Duration of Response (DOR) in patients who achieve partial response (PR) or better (Time Frame (Group 2): from date of documented PR or better to date of first documented tumor progression or death, whichever comes first (up to 5 years)), Progression Free Survival (PFS) (Time Frame (Group 2): From first dose to date of first documented tumor progression or death, whichever comes first (up to 5 years)), Overall Survival (OS) (Time Frame: From first dose to the date of death due to any cause (up to 5 years)), ORR, DCR, DOR, PFS and OS for patients with PD-L1-positive tumor expression (>1% positive tumor cells) and/or positive LAG-3 expression (i.e. >1% positive tumor-infiltrationg cells), Safety and toxicity of Nivolumab plus Relatlimab (Group 2)

Source: https://euclinicaltrials.eu/ctis-public/view/2024-513637-20-00